EU clinical trial 2023-504946-70-00: Withdrawal of Pharmacological Treatment in Patients Responding to Cardiac Resynchronization Therapy: (REMOVE)
Protocol code: IMIB-RMV-2021-02
Sponsor: Fundacion Para La Formacion E Investigacion Sanitaria De La Region De Murcia (Educational Institution). Phase: Therapeutic use (Phase IV). Countries: Spain (ongoing, recruitment ended).
Therapeutic area(s): Diseases [C] - Cardiovascular Diseases [C14]
Gender: Female, Male. Age: 18-64 years, 65+ years. Enrolment: 60.
Status: Ongoing, recruitment ended. Start date (EU): 2021-12-01. Decision date: 2023-04-24. Results received: No. Last updated: 2024-05-20.

Condition(s): Heart Failure
Product: eplerenona cinfa 50 mg comprimidos recubiertos con película EFG, eplerenona cinfa 25 mg comprimidos recubiertos con película EFG, Diován Cardio 40 mg comprimidos recubiertos con película, Diován 320 mg comprimidos recubiertos con película, Bisoprolol Cor Aristo 10 mg comprimidos recubiertos con película EFG, Bisoprolol Cor Aristo 5 mg comprimidos recubiertos con película EFG, Furosemida KERN PHARMA 40 mg comprimidos EFG, Bisoprolol Cor Aristo 2,5 mg comprimidos recubiertos con película EFG, Diován 80 mg comprimidos recubiertos con película, Diován 160 mg comprimidos recubiertos con película

Primary endpoint: Relapse of cardiomyopathy at any time during the study after drug withdrawal, defined by at least one of the following: 1. A reduction in LVEF of more than 10% (as long as the overall LVEF is < 50%). 2. A reduction in LVEF of more than 10% accompanied by a >15% increase in left ventricular end-systolic volume. 3. Unplanned hospital admission or visit to the Emergency Department/day hospital due to decompensated HF requiring the administration of intravenous diuretics.
Endpoint(s): Combined total mortality, cardiovascular mortality, hospital admission or visit to the Emergency Department/unplanned day hospital for HF, and sustained atrial or ventricular arrhythmias (>30 seconds)., Changes with respect to the basal levels of BP and HR., Change from baseline in LVEF, LVTVV, left atrial volume indexed by body surface area (VAIi), and changes from baseline in left ventricular (LV) longitudinal global strain (LSG)., Quantitative changes in NT-proBNP numbers., Changes in the quality of life questionnaires according to The Kansas City Cardiomyopathy Questionnaire (KCCQ) and Minnesota Living With Heart Failure (MLHFQ) scale.

Source: https://euclinicaltrials.eu/ctis-public/view/2023-504946-70-00